EU clinical trial 2025-521795-58-00: Contrast Strategy In Fenestrated EndoVascular Aneurysm Repair Randomized Control Trial
Sponsor: Region Skane (Hospital/Clinic/Other health care facility). Phase: Phase III and phase IV (Integrated). Countries: Sweden (authorised, recruitment pending), Denmark (authorised, recruitment pending).
Therapeutic area(s): Diseases [C] - Cardiovascular Diseases [C14]
Gender: Female, Male. Age: 18-64 years, 65+ years. Enrolment: 293.
Status: Authorised, recruitment pending. Decision date: 2025-12-16. Results received: No. Last updated: 2026-06-25.
Decision dates by country: DK: 2026-06-25, SE: 2025-12-16

Condition(s): Abdominal aortic aneurysm
Product: Omnipaque 180 mg I/ml Injektionslösung, Iomeron 150 mg I/ml injektionsvätska, lösning, Visipaque 270 mg I/ml Injektionslösung

Primary endpoint: Incidence of patients with AKI, defined as RIFLE stage R (Risk) and above during the early postoperative period according to the RIFLE classification (Risk, Injury, Failure, Loss of kidney function, End-stage kidney disease) suggested in the reporting standards for complex aortic repair.
Endpoint(s): Kidney function; Incidence of patients developing AKI stage 1 and above, according to KDIGO classification, based on Serum creatinine assessment and urinary output, Success of surgery; Number and percent of patients fulfilling the definitions of the immediate technical and primary and secondary clinical successes (calculated with the life-tables), based on clinical and imaging endpoints at the FEVAR and CT during follow-up at 1 months and yearly up to 3 years, Intraoperative imaging assessment: - Image quality assessed by a 5-point Likert scale; -Incidence of detected endoleaks and their type; - Radiation exposure and Absorbed Dose, Percentage of patients experiencing adverse events until discharge and adverse events of special interest up to 3 years after FEVAR (number, type and severity), The quality of life before and after the procedure measured by the EQ-5D-5l instrument preoperatively, at discharge, 1 month, and 1, 2, and 3 years, Swedish Quality of Recovery Scale (SwQoR) at day 2 postoperatively; and MoCa before the procedure and at 1 month, Survival up to 3 years (percent of surviving patients), Percentage of patients whose cause of death is related to aortic repair and renal insufficiency, up to 3 years after FEVAR, Percentage of patients with CKD stage 2 and above within 3 years, according to the National Kidney Foundation Kidney Disease Outcomes Quality Initiative classification, based on the assessment of eGFR, Percentage of patients with worsening of CKD stage within 3 years according to the National Kidney Foundation Kidney Disease Outcomes Quality Initiative classification, based on the assessment of eGFR, Reintervention

Source: https://euclinicaltrials.eu/ctis-public/view/2025-521795-58-00